EU clinical trial 2022-503089-57-00: Exploratory study of the expression of the serotonergic 5-HT4 receptor in Parkinson's disease
Protocol code: 69HCL22_0953
Sponsor: Hospices Civils De Lyon (Hospital/Clinic/Other health care facility). Phase: Phase II and Phase III (Integrated). Countries: France (ongoing, recruitment ended).
Therapeutic area(s): Phenomena and Processes [G] - Musculoskeletal and Neural Physiological Phenomena [G11]
Gender: Female, Male. Age: 18-64 years, 65+ years. Enrolment: 35.
Status: Ongoing, recruitment ended. Start date (EU): 2023-09-18. Decision date: 2023-08-25. Results received: No. Last updated: 2024-05-22.

Condition(s): Parkinson disease
Product: [C11]-SB207145

Primary endpoint: the difference in binding of the radiotracer [11C]SB207145 to the 5-HT4 receptor between Parkinsonian patients and control subjects. For each subject, the specific binding of the tracer will be calculated for each voxel with respect to a reference zone (the white matter of the cerebellum).
Endpoint(s): the description of the relationship between the level of expression of the tracer and the clinical scores on the scales of motor, non-motor, cognitive and psycho-behavioural symptoms., the description of the relationship between the expression level of the tracer and the polymorphism data.

Source: https://euclinicaltrials.eu/ctis-public/view/2022-503089-57-00